EU clinical trial 2026-525342-29-00: A Study to Establish the Bioequivalence of Free Acid Tafamidis 61 mg Capsule and Tablet, and Evaluate the Safety and Tolerability of the 61 mg Tablet in Healthy Adults Under Fed Conditions
Protocol code: B3461131
Sponsor: Pfizer Inc. (Pharmaceutical company). Phase: Human Pharmacology (Phase I)- Bioequivalence Study. Countries: Belgium (ended).
Therapeutic area(s): Diseases [C] - Pathological Conditions, Signs and Symptoms [C23]; Diseases [C] - Musculoskeletal Diseases [C05]
Gender: Female, Male. Age: 18-64 years, 65+ years. Enrolment: 24.
Status: Ended. Start date (EU): 2026-03-16. End date (EU): 2026-06-02. Decision date: 2026-03-11. Results received: No. Last updated: 2026-04-03.

Condition(s): Transthyretin amyloidosis

Source: https://euclinicaltrials.eu/ctis-public/view/2026-525342-29-00